EU clinical trial 2022-501608-85-00: A Double-blind, Randomized, Placebo-controlled, Multicenter Study Assessing the Impact of Olpasiran on Major Cardiovascular Events in Patients with Atherosclerotic Cardiovascular Disease and Elevated Lipoprotein (a)
Protocol code: 20180244
Sponsor: Amgen Inc. (Pharmaceutical company). Phase: Therapeutic confirmatory (Phase III). Countries: Slovakia (ongoing, recruitment ended), Poland (ongoing, recruitment ended), Greece (ongoing, recruitment ended), Netherlands (ongoing, recruitment ended), Germany (ongoing, recruitment ended), Czechia (ongoing, recruitment ended), Spain (ongoing, recruitment ended), France (ongoing, recruitment ended), Hungary (ongoing, recruitment ended), Bulgaria (ongoing, recruitment ended), Norway (ongoing, recruitment ended), Denmark (ongoing, recruitment ended), Lithuania (ongoing, recruitment ended), Estonia (ongoing, recruitment ended), Iceland (ongoing, recruitment ended), Portugal (ongoing, recruitment ended), Finland (ongoing, recruitment ended), Belgium (ongoing, recruitment ended), Sweden (ongoing, recruitment ended), Italy (ongoing, recruitment ended), Austria (ongoing, recruitment ended), Romania (ongoing, recruitment ended).
Therapeutic area(s): Diseases [C] - Cardiovascular Diseases [C14]
Gender: Female, Male. Age: 18-64 years, 65+ years. Enrolment: 3190.
Status: Ongoing, recruitment ended. Start date (EU): 2023-05-09. Decision date: 2023-05-03. Results received: No. Last updated: 2026-08-03.
Decision dates by country: FI: 2023-05-22, HU: 2023-05-10, BE: 2023-05-04, SK: 2023-05-04, PL: 2023-05-08, AT: 2023-05-15, FR: 2023-05-05, BG: 2023-05-15, IS: 2023-05-22, EE: 2023-05-12, CZ: 2023-05-10, SE: 2023-05-05, NO: 2023-05-08, RO: 2023-05-22, LT: 2023-05-22, DK: 2023-05-03, DE: 2023-05-09, GR: 2023-05-09, PT: 2023-05-03, IT: 2023-05-05, ES: 2023-05-22, NL: 2023-05-10

Condition(s): Cardiovascular disease (atherosclerotic cardiovascular disease (ASCVD) and elevated lipoprotein (a))
Product: Placebo for AMG 890, Olpasiran, Olpasiran

Primary endpoint: Time to CHD death, myocardial infarction, or urgent coronary revascularization, whichever occurs first
Endpoint(s): Time to cardiovascular death, myocardial infarction, or ischemic stroke, whichever occurs first, Time to cardiovascular death, myocardial infarction, urgent coronary revascularization, or ischemic stroke, whichever occurs first, Percent change from baseline to week 48 in Lp(a), • time to myocardial infarction • time to CHD death or myocardial infarction, whichever occurs first • time to urgent coronary revascularization • time to coronary revascularization • time to CHD death • time to cardiovascular death • time to death by any cause • time to ischemic stroke, Treatment-emergent adverse events (including clinically significant changes in laboratory values and vital signs), serious adverse events, and adverse events leading to discontinuation of investigational product, serum concentration of olpasiran at selected timepoints

Source: https://euclinicaltrials.eu/ctis-public/view/2022-501608-85-00